EU clinical trial 2024-515009-24-00: INTRATUMORAL DNX-2401 ADMINISTRATION FOR RECURRENT AND REFRACTORY HIGH GRADE BRAIN TUMORS IN PEDIATRIC AND YOUNG ADULT PATIENTS
Sponsor: Clinica Universidad De Navarra (Hospital/Clinic/Other health care facility). Phase: Therapeutic exploratory (Phase II). Countries: Netherlands (authorised, recruitment pending), Spain (ongoing, recruiting).
Therapeutic area(s): Diseases [C] - Nervous System Diseases [C10]
Gender: Female, Male. Age: 0-17 years, 18-64 years. Enrolment: 39.
Start date (EU): 2026-05-08. Decision date: 2026-03-11. Results received: No. Last updated: 2026-07-02.
Decision dates by country: NL: 2026-03-23, ES: 2026-03-11

Condition(s): High grade malignant brain neoplasm

Primary endpoint: Overall response rate (ORR), defined as the percentage of patients with complete response (CR), partial response (PR), or stable disease (SD for at least 12 weeks) as best response according to RAPNO criteria.
Endpoint(s): Number of AEs and SAEs per NCI-CTCAE criteria in first 12 weeks after DNX-2401 administration., Time to response., Duration of response., PFS, OS: 6- and 12- month PFS and OS rates., LPS/KPS and QoL (PedsQL™ Generic Score Scale) parameters compared to baseline.

Source: https://euclinicaltrials.eu/ctis-public/view/2024-515009-24-00